EU clinical trial 2023-505639-11-00: A Phase 3b Study to Evaluate Higher Dose Nusinersen (BIIB058) in Patients with Spinal Muscular Atrophy Previously Treated with Risdiplam - ASCEND
Protocol code: 232SM303
Sponsor: Biogen Idec Research Limited (Pharmaceutical company). Phase: Therapeutic confirmatory (Phase III). Countries: Germany (ongoing, recruitment ended), Italy (ongoing, recruitment ended), Hungary (ongoing, recruitment ended).
Therapeutic area(s): Diseases [C] - Musculoskeletal Diseases [C05]
Gender: Female, Male. Age: 0-17 years, 18-64 years. Enrolment: 22.
Status: Ongoing, recruitment ended. Start date (EU): 2022-09-14. Decision date: 2024-06-19. Results received: No. Last updated: 2026-05-21.
Decision dates by country: HU: 2024-06-19, IT: 2024-07-02, DE: 2024-06-21

Condition(s): Spinal Muscular Atrophy
Product: SPINRAZA 28 mg, SPINRAZA 50 mg

Primary endpoint: Change in Total Revised Upper Limb Module (RULM) Score [ Time Frame: Up to Day 855 ]
Endpoint(s): Number of Participants With Adverse Events (AEs) and Serious Adverse Events (SAEs) [ Time Frame: Up to Day 1695 ], Number of Participants With Change in Clinical Laboratory Parameters, Electrocardiogram (ECG), Vital Signs and Pulse Oximetry from Baseline [ Time Frame: Up to Day 1695 ]

Source: https://euclinicaltrials.eu/ctis-public/view/2023-505639-11-00